EU clinical trial 2023-509713-37-00: SYMBOL CLINICAL : Treatment of severe ocular chemical burns by subconjunctival injection of allogeneic mesenchymal stem cells: a multicentre, single-arm, open-label phase II trial
Protocol code: SYMBOL CLINICAL
Sponsor: Hopital Fondation Adolphe De Rothschild (Hospital/Clinic/Other health care facility). Phase: Therapeutic exploratory (Phase II). Countries: France (authorised, recruitment pending).
Therapeutic area(s): Diseases [C] - Eye Diseases [C11]
Gender: Female, Male. Age: 18-64 years, 65+ years. Enrolment: 21.
Status: Authorised, recruitment pending. Decision date: 2025-12-09. Results received: No. Last updated: 2025-12-09.

Condition(s): Patient with severe eye chemical burns
Product: FLUORESCEINE FAURE 0,5 POUR CENT, collyre en solution en récipient unidose, PARACETAMOL AGUETTANT 10 mg/ml, solution pour perfusion, STERDEX, pommade ophtalmique en récipient unidose, CHLORHYDRATE D’OXYBUPROCAINE THEA 1,6 mg/0,4 ml, collyre en récipient unidose, MIDAZOLAM VIATRIS 5 mg/ml, solution injectable ou rectale, PROPOFOL FRESENIUS 10 mg/ml, émulsion injectable ou pour perfusion, ALBUTEIN 50 g/L, solution pour perfusion, Bone marrow-derived Mesenchymal Stromal Cells cryopreserved at passage P2, thawed, washed and syringe-conditioned in 0.9% NaCl - 0.5% human serum albumin injection solution at a dose of 5.10^6 Mesenchymal Stromal Cells, IBUPROFENE ARROW 400 mg, comprimé pelliculé, DOLIPRANE 500 mg, gélule, BETADINE 5 POUR CENT, solution pour irrigation oculaire en récipient unidose, REMIFENTANIL VIATRIS 2 mg, poudre pour solution injectable ou pour perfusion

Primary endpoint: Absence of corneal perforation as assessed by the clinician
Endpoint(s): All criteria refer to the eye receiving treatment in the study: Assessed by the clinician using a fluorescein test at the slit lamp examination., All criteria refer to the eye receiving treatment in the study: Classification by the LSCD international working group, All criteria refer to the eye receiving treatment in the study: Tauber and Foster classification, All criteria refer to the eye receiving treatment in the study: Percentage of HLA-DR positive cells on conjunctival impression cytology, All criteria refer to the eye receiving treatment in the study: Snellen scale, All criteria refer to the eye receiving treatment in the study: OCT of the anterior segment (Optical Coherence Tomography), All criteria refer to the eye receiving treatment in the study: Collected from the patient's medical file, All criteria refer to the eye receiving treatment in the study: Collected from the patient's medical file, All criteria refer to the eye receiving treatment in the study: Incidence rate, type and severity of adverse events

Source: https://euclinicaltrials.eu/ctis-public/view/2023-509713-37-00